EU clinical trial 2024-517772-38-00: Evaluation of Botulinum TOXin type A in the treatment of Buerger’s disease
Protocol code: RC31/20/0445
Sponsor: Centre Hospitalier Universitaire De Toulouse (Hospital/Clinic/Other health care facility). Phase: Phase II and Phase III (Integrated). Countries: France (authorised, recruitment pending).
Therapeutic area(s): Diseases [C] - Nutritional and Metabolic Diseases [C18]
Gender: Female, Male. Age: 18-64 years, 65+ years. Enrolment: 8.
Status: Authorised, recruitment pending. Decision date: 2024-10-22. Results received: No. Last updated: 2024-10-22.

Condition(s): Buerger's disease
Product: Botulinum Toxin Type A 500 units Powder for solution for injection

Primary endpoint: The primary endpoint is feasibility. The feasibility endpoint corresponds to the number of patients who actually received the planned injections within the defined timeframes, among the patients who should have had the injection according to the protocol criteria.
Endpoint(s): Tolerance assessment. The tolerance criterion is assessed according to the practitioner by collecting temporary adverse events that are associated with the specific research procedure and that are expected and by severe adverse events., Evaluation of critical ischemia parameters: Evaluation of tissue perfusion by laser Doppler, toe pressure or digital pressure in mmHg before (D0) and after injection (M1, M3, M6) Evaluation of tissue perfusion by thermal camera before (D0) and after injection (M1, M3, M6) Transcutaneous measurement of partial oxygen pressure TCPO2 before (D0) and after injection (M1, M3, M6), Pain assessment, evaluated by VAS at M1, M3, M6, Assessment of healing of distal ulcers (D0, M1, M3, M6) - color scale (% of bud, fibrin, necrosis, epidermization) at D0, M1, M3, M6 - size, surface of ulcers at D0, M1, M3, M6 - new distal ulcerations at D0, M1, M3, M6 - number of ulcers whose surface has reduced by more than 40% at M1, M3, M6 - number of total healing (100% epidermization) at M1, M3, M6 - number of minor or major amputations at M1, M3, M6, Appearance of new digital ulcers, Need for minor and major amputation, Frequency and severity of Raynaud's syndrome associated with Buerger's disease according to the Raynaud condition score (D0, M1, M3, M6) An attack is defined as a paroxysmal episode of pallor or cyanosis to cold (with or without pain, tingling or numbness). Patients will note daily the number and duration of RA attacks as well as the severity of the RA, each attack is self-assessed daily on a 10-point scale and the average calculated over the 14 days, Evaluation of quality of life questionnaires (EQ-5D-5L, Cochin, Claus) at D0 and M6

Source: https://euclinicaltrials.eu/ctis-public/view/2024-517772-38-00